EU clinical trial 2023-510201-18-00: Advancing the quality of treatment and care for acute agitation in emergency psychiatry
Sponsor: Region Hovedstaden (Hospital/Clinic/Other health care facility). Phase: Phase II and Phase III (Integrated). Countries: Denmark (ongoing, recruiting).
Therapeutic area(s): Psychiatry and Psychology [F] - Behavior and Behavior Mechanisms [F01]
Gender: Female, Male. Age: 18-64 years. Enrolment: 132.
Status: Ongoing, recruiting. Start date (EU): 2024-12-27. Decision date: 2024-06-10. Results received: No. Last updated: 2026-03-10.

Condition(s): acute agitation
Product: Midazolam Medical Valley 10 mg munhålelösning, Igalmi, Lorazepam Orion 1 mg tabletter

Primary endpoint: PANSS Excited Component (PEC) score at 60 minutes post-dose (change from pre- to post-dose)
Endpoint(s): The earliest time where a statistically significant difference in agitation is apparent as measured by change from baseline PEC score (change from pre- to post-dose PEC score at 30, 60, 90, and 120 minutes), Proportion tranquillized or asleep (measured as ≤4 on the BARS**) by 30, 60, 90, and 120 minutes post-dose, Proportion physically restrained from administration to 12 hours post-dose, Proportion mechanically restrained from administration to 12 hours post-dose, Proportion given rescue medication 4-12 hours post-dose, Patient-reported satisfaction measured using 4 items from the Treatment Satisfaction Questionnaire for Medication II

Source: https://euclinicaltrials.eu/ctis-public/view/2023-510201-18-00